EU clinical trial 2022-502643-35-00: A Double-Masked, Randomized, Placebo-Controlled, Parallel-Group, 12 Week Administration With Two-Week Gradual Dose Taper Phase and 38-Week Follow-Up Phase, Phase 3 Study to Investigate the Safety and Efficacy of Ripasudil (K-321) Eye Drops After Simultaneous Cataract Surgery and Descemetorhexis in Subjects with Fuchs Endothelial Corneal Dystrophy
Protocol code: K-321-303
Sponsor: Kowa Research Institute Inc. (Pharmaceutical company). Phase: Therapeutic confirmatory (Phase III). Countries: Germany (ended), Denmark (ended), Spain (ended).
Therapeutic area(s): Diseases [C] - Eye Diseases [C11]
Gender: Female, Male. Age: 18-64 years, 65+ years. Enrolment: 41.
Status: Ended. Start date (EU): 2023-08-09. End date (EU): 2025-10-17. End date: 2025-10-24. Decision date: 2023-07-21. Results received: No. Last updated: 2025-03-21.
Decision dates by country: DK: 2023-07-21, DE: 2023-07-21, ES: 2023-07-24

Condition(s): Fuchs Endothelial Corneal Dystrophy
Product: Ripasudil, The placebo is presented as sterile non-preserved unit dose eye drops that do not contain Ripasudil hydrochloride dihydrate. For the proposed study the eye drops are packaged in 0.3ml quantities in clear additive free polyethylene blow-fill-seal ampoules.

Primary endpoint: Time to ≥40 ETDRS letter improvement in BCVA during the first 12 weeks after simultaneous cataract surgery and descemetorhexis.
Endpoint(s): Time to ≥20 ETDRS letter improvement during the first 12 weeks after simultaneous cataract surgery and descemetorhexis., Time to achievement of ≥70 ETDRS letters during the first 12 weeks after simultaneous cataract surgery and descemetorhexis., Central corneal ECD change from baseline at Week 12.

Source: https://euclinicaltrials.eu/ctis-public/view/2022-502643-35-00